EU clinical trial 2023-506879-98-00: A multi-centre, open, prospective, randomized, parallel-group, 24-month study to compare the outcome of receiving continued immunosuppression versus stopping immunosuppression at 6 months to safely prevent human leukocyte antigen (HLA) sensitization in patients with late renal graft failure
Protocol code: PREVSENSI
Sponsor: Vall D'hebron Institut De Recerca (Laboratory/Research/Testing facility). Phase: Therapeutic use (Phase IV). Countries: Spain (ongoing, recruiting).
Therapeutic area(s): Diseases [C] - Pathological Conditions, Signs and Symptoms [C23]
Gender: Female, Male. Age: 18-64 years, 65+ years. Enrolment: 202.
Status: Ongoing, recruiting. Start date (EU): 2024-01-22. Decision date: 2023-11-10. Results received: No. Last updated: 2026-03-25.

Condition(s): Renal transplantation
Product: Conferoport 3 mg cápsulas duras de liberación prolongada EFG, Sandimmun Neoral 100 mg cápsulas blandas, Envarsus 4 mg prolonged-release tablets, Sandimmun Neoral 25 mg cápsulas blandas, Advagraf 3 mg prolonged-release hard capsules, Prograf 1 mg Cápsulas duras, Advagraf 1 mg prolonged-release hard capsules, Envarsus 0.75 mg prolonged-release tablets, Prograf 5 mg Cápsulas duras, Adoport 5 mg cápsulas duras EFG, Adoport 1 mg cápsulas duras EFG, Prograf 0,5 mg Cápsulas duras, Conferoport 2 mg cápsulas duras de liberación prolongada, Sandimmun Neoral 50 mg cápsulas blandas, Conferoport 0,5 mg cápsulas duras de liberación prolongada EFG, Conferoport 5 mg cápsulas duras de liberación prolongada EFG, Adoport 0,5 mg cápsulas duras EFG, Advagraf 0.5 mg prolonged-release hard capsules, Conferoport 1 mg cápsulas duras de liberación prolongada EFG, Adoport 2 mg cápsulas duras, Envarsus 1 mg prolonged-release tablets, Advagraf 5 mg prolonged-release hard capsules

Primary endpoint: The primary variable will be the difference between the two treatment arms in the degree of HLA sensitization at 2-years measured as cPRA (%).

Source: https://euclinicaltrials.eu/ctis-public/view/2023-506879-98-00